EU clinical trial 2024-512790-27-00: A phase I/II, non randomized, monocentric open-label study of autologous CD34+ cells transduced with the G1XCGD lentiviral vector in patients with X-linked chronic granulomatous disease
Protocol code: G1XCGD.02
Sponsor: Genethon (Laboratory/Research/Testing facility). Phase: Phase I and Phase II (Integrated)- First administration to humans. Countries: France (ended).
Therapeutic area(s): Diseases [C] - Immune System Diseases [C20]
Gender: Male. Age: 0-17 years, 18-64 years. Enrolment: 5.
Status: Ended. Start date (EU): 2016-04-19. End date (EU): 2025-10-17. Decision date: 2024-07-10. Results received: No. Last updated: 2024-12-04.

Condition(s): Treatment of X-linked Chronic Granulomatous Disease
Product: G1XCGD (lentiviral vector transduced CD34+ cells)

Primary endpoint: Safety as measured by the incidence of adverse events due either to the conditioning regimen, the IMP or to the procedure itself., Efficacy as measured by the restoration and stability over time of the NADPH functioning granulocytes assessed by a DHR test (≥ 5% of expressing cells at 12 months).
Endpoint(s): Normalisation of nutritional status, growth, development (as measured by clinical evaluation), clearing of the pre-existing severe infection and/or chronic inflammatory lesions which recommended patient’s inclusion, Percentage of transduced CD34+ haematopoietic stem cell at one year and percentage of transduced mature blood cells over time, Immunological reconstitution as measured by evidence of restored neutrophil functionality and immunity against bacterial and fungal infections over time.

Source: https://euclinicaltrials.eu/ctis-public/view/2024-512790-27-00